EU clinical trial 2023-510481-27-00: FLUOPANC II: A performance study of SGM-101, a fluorochrome-labeled anti-carcinoembryonic antigen monoclonal antibody for fluorescence-guided imaging to determine local extent and resectability during surgical resection of pancreatic ductal adenocarcinoma after neoadjuvant treatment.
Sponsor: Academisch Ziekenhuis Leiden (Hospital/Clinic/Other health care facility). Phase: Therapeutic exploratory (Phase II). Countries: Netherlands (ended).
Therapeutic area(s): Analytical,Diagnostic,Therapeutic Techniques and Equipment [E]-Surgical Procedures, Operative [E04]; Diseases [C] - Digestive System Diseases [C06]; Diseases [C] - Neoplasms [C04]
Gender: Female, Male. Age: 18-64 years, 65+ years. Enrolment: 60.
Status: Ended. Start date (EU): 2023-12-11. End date (EU): 2026-03-23. Decision date: 2024-10-01. Results received: No. Last updated: 2024-10-01.

Condition(s): Pancreatic tumor
Product: SGM-101

Primary endpoint: The ability to visualize the primary pancreatic tumor, the local tumor extent and resectability status, with adjacent lymph nodes and to visualize also potential distant metastatic lesions, using SGM-101 and dedicated NIR-imaging systems.
Endpoint(s): Concordance to pathology results with respect to the presence of cancer and the imaging assessment, based on fluorescent signal and the tumor status (incl. degree of CEA-expression) of biopsied or resected tissue. Measured by calculation of the sensitivity for accurate (tumor+) signal., Detection and quantification of circulating TiMas in samples of (porto) venous blood, lymph fluid and the lymphatic system obtained during surgery and follow-up, Detection, quantification and characterization of tdEVs in portal-vein blood samples through flow cytometry, glycomics and cryo-electron microscopy. The data obtained will be correlated with clinical parameters, Detection, quantification and characterization of tdEVs in peripheral blood samples through flow cytometry, glycomics and cryo-electron microscopy. The data obtained will be compared to data from portal-vein blood samples and correlated with clinical parameters

Source: https://euclinicaltrials.eu/ctis-public/view/2023-510481-27-00